EU clinical trial 2023-508785-16-00: Efficacy of dexmedetomidine versus midazolam sedation on extubation time in mechanically ventilated preterm infants: a randomized controlled multicenter trial (DEXPRE)
Protocol code: APHP230813
Sponsor: Assistance Publique Hopitaux De Paris (Hospital/Clinic/Other health care facility). Phase: Therapeutic confirmatory (Phase III). Countries: France (ongoing, recruiting).
Therapeutic area(s): Diseases [C] - Congenital, Hereditary, and Neonatal Diseases and Abnormalities [C16]
Gender: Female, Male. Age: 0-17 years. Enrolment: 380.
Status: Ongoing, recruiting. Start date (EU): 2025-10-17. Decision date: 2024-08-23. Results received: No. Last updated: 2026-07-22.

Condition(s): Very preterm neonate (gestational age at birth < 32 WG) with corrected gestational age <45 WG) with indication for sedation in the context of invasive mechanical ventilation
Product: DEXMEDETOMIDINE EVER PHARMA 100 microgrammes/mL, solution à diluer pour perfusion, MIDAZOLAM

Primary endpoint: Time-to-extubation after discontinuation of dexmedetomidine-based sedation versus discontinuation of midazolam-based sedation in very preterm neonates.
Endpoint(s): Administration of opioid agents during the period of interest, i.e., from the start of treatment (DEX or midazolam) until extubation, Time (in hours) between start of sedation and achievement of a normal Comfort B score (ie. between 11 and 17)., Intubation rate at 24 hours after extubation., Proportion of patients with at least one value of the Finnegan score > 8 from within 3 days after extubation., Hemodynamic and respiratory adverse event from start of the sedation until 84 h after the sedative is stopped defined as: bradycardia, hemodynamic instability, desaturation <85% despite optimization of mechanical ventilation, reintubation, In-hospital mortality, Severe neonatal morbidity

Source: https://euclinicaltrials.eu/ctis-public/view/2023-508785-16-00